EU clinical trial 2024-516822-67-00: A Phase 2/3, Multicenter, Open-Label Phase Followed by a Double-Blind, Randomized, Placebo-Controlled Study to Evaluate the Efficacy and Safety of Infigratinib in Children with Hypochondroplasia: ACCEL 2/3
Protocol code: QBGJ398-304
Sponsor: Qed Therapeutics Inc. (Pharmaceutical company). Phase: Phase II and Phase III (Integrated). Countries: Norway (ongoing, recruiting), France (authorised, recruitment pending), Sweden (authorised, recruitment pending), Portugal (authorised, recruitment pending), Spain (ongoing, recruiting).
Therapeutic area(s): Diseases [C] - Congenital, Hereditary, and Neonatal Diseases and Abnormalities [C16]
Gender: Female, Male. Age: 0-17 years. Enrolment: 32.
Start date (EU): 2025-08-14. Decision date: 2025-07-15. Results received: No. Last updated: 2026-03-11.
Decision dates by country: ES: 2025-07-17, FR: 2025-07-15, NO: 2025-07-15, PT: 2025-07-17, SE: 2025-07-16

Condition(s): Hypochondroplasia
Product: PLACEBO, Infigratinib, INFIGRATINIB, INFIGRATINIB, INFIGRATINIB, INFIGRATINIB

Primary endpoint: ACCEL 2: Change from baseline (BL) in height velocity (HV) at Week 26 (annualized to cm/year). ACCEL 3: Change from BL to Week 52 in AHV compared to placebo.
Endpoint(s): ACCEL 2: Change from BL in height Z-score (in relation to both HCH and average height tables for age and sex) compared to placebo., ACCEL 3: Change from BL to Week 52 in upper to lower body segment ratio, compared to placebo.

Source: https://euclinicaltrials.eu/ctis-public/view/2024-516822-67-00